EU clinical trial 2023-506935-14-01: Intra-Arterial thrombolysis after SUCCESSful angiographic recanalization in acute large vessel occlusion stroke of the anterior circulation: the IA-SUCCESS multicenter, randomized clinical trial
Protocol code: 2020PI054
Sponsor: CHRU De Nancy (Hospital/Clinic/Other health care facility). Phase: Therapeutic confirmatory (Phase III). Countries: France (ongoing, recruiting).
Therapeutic area(s): Diseases [C] - Cardiovascular Diseases [C14]
Gender: Female, Male. Age: 18-64 years, 65+ years. Enrolment: 626.
Status: Ongoing, recruiting. Start date (EU): 2025-06-01. Decision date: 2024-09-12. Results received: No. Last updated: 2025-04-16.

Condition(s): Ischemic stroke
Product: ACTILYSE, poudre et solvant pour solution injectable et perfusion

Primary endpoint: The primary endpoint is the severity of disability according to the shift of scores on the modified Rankin Scale (mRS) at 90 (±15) days.
Endpoint(s): 1a) EFFICACY: -Distribution of the mRS score at day 90 (±15)., 1a) EFFICACY: -Excellent functional outcome (mRS 0-1) at 90 (±15) day., 1a) EFFICACY: -Functional independence (mRS 0-2) at 90 (±15) day., 1a) EFFICACY: -Early neurological improvement (reduction in National Institutes of Health Stroke Scale (NIHSS) score by at least 8 points, or NIHSS score of 0-1) at 24 (±6) hours., 1a) EFFICACY: -eTICI at the end of endovascular procedure (including IA thrombolysis in the intervention group)., 1a) EFFICACY: -Infarct growth: difference in (i) ASPECTS scores and (ii) infarct core volume (MRI DWI or CT perfusion) between 24 (±6) hours and baseline, 1b) SAFETY: -Complications during endovascular treatment: arterial perforation, extracranial carotid dissection, embolization in a new territory., 1b) SAFETY: -Symptomatic and asymptomatic intracerebral hemorrhage within 24-hour on CT or MRI, according to the Heidelberg classification (imaging core laboratory)., 1b) SAFETY: -Extracranial hemorrhage requiring transfusion, surgery or resulting in death, 1b) SAFETY: -Death from all causes within 90 (±15) days, 2) COST EFFECTIVENESS: Incremental cost-effectiveness and cost-utility ratios of a strategy based on adjunct IA thrombolysis in case of successful angiographic reperfusion compared with a strategy of no adjunct IA thrombolysis., 3) TOTAL COST: Total cost of each treatment strategy and net impact on the National Health Insurance System (difference in costs).

Source: https://euclinicaltrials.eu/ctis-public/view/2023-506935-14-01